EU clinical trial 2023-509332-26-00: An adaptive, randomized, double-blind, dose exploration, parallel group, placebo controlled, multicenter phase 2 trial to evaluate the efficacy, safety and tolerability of LNP023 in combination with standard-of-care with and without oral corticosteroids in adult patients with active lupus nephritis Class III-IV, +/- V
Protocol code: CLNP023K12201
Sponsor: Novartis Pharma AG (Pharmaceutical company). Phase: Therapeutic exploratory (Phase II). Countries: France (ongoing, recruiting), Hungary (ongoing, recruiting), Portugal (ongoing, recruiting), Germany (ongoing, recruiting), Spain (ongoing, recruiting).
Therapeutic area(s): Diseases [C] - Immune System Diseases [C20]
Gender: Female, Male. Age: 18-64 years, 65+ years. Enrolment: 48.
Status: Ongoing, recruiting. Start date (EU): 2023-02-16. Decision date: 2024-07-15. Results received: No. Last updated: 2025-12-30.
Decision dates by country: DE: 2024-07-25, FR: 2024-08-13, HU: 2024-07-17, ES: 2024-07-15, PT: 2024-07-17

Condition(s): Lupus Nephritis Class III-IV, +/- V
Product: MYCOPHENOLIC ACID, PREDNISONE, MYCOPHENOLATE SODIUM, PREDNISONE, MYCOPHENOLATE SODIUM, Placebo 0 mg hard gelatin capsule size 0 and size 2, (placebo to LNP023), METHYLPREDNISOLONE, IPTACOPAN, PREDNISONE, PREDNISONE, PREDNISONE, PREDNISONE, LNP023, Placebo to prednisone

Primary endpoint: Part 1 and 2: Proportion of patients achieving Complete Renal Response (CRR) at week 24 in the absence of renal flares
Endpoint(s): Parts 1 and 2: Proportion of patients achieving CRR or PRR in the absence of renal flares at weeks 24 and 52, Time-to-Complete Renal Response (CRR) based on first morning void (FMV) urine samples, Proportion of patients achieving ≥25% UPCR reduction in the absence of renal flares compared to baseline at week 24, Frequency of courses of corticosteroids for renal and non-renal indications at a dose exceeding an average of 20mg/day (of prednisolone or equivalent) for more than 10 days between weeks 24 and 52, Change from baseline FACIT-Fatigue Score at weeks 24 and 52, Change from baseline in SLEDAI-2K score at weeks 24 and 52, Change from baseline in BILAG-2004 score at weeks 24 and 52, Safety endpoints up to week 52 for Part 1 and 2, Log-transformed ratio to baseline of 24h UPCR at week 24

Source: https://euclinicaltrials.eu/ctis-public/view/2023-509332-26-00